EU clinical trial 2024-514268-18-00: I4C-MC-JTBB: A Randomized, Controlled Phase 2 Study Evaluating LY2875358 plus Erlotinib versus Erlotinib as First-Line Treatment in Metastatic NSLC Patients with Activating EGFR Mutations Who Have Disease Control after an 8-Week Lead-In Treatment with Erlotinib
Protocol code: I4C-MC-JTBB
Sponsor: Eli Lilly & Co. (Pharmaceutical company). Phase: Therapeutic exploratory (Phase II). Countries: Spain (ended), Germany (ended).
Therapeutic area(s): Diseases [C] - Neoplasms [C04]
Gender: Female, Male. Age: 18-64 years, 65+ years. Enrolment: 2.
Status: Ended. Start date (EU): 2013-09-06. End date (EU): 2026-01-08. End date: 2026-01-09. Decision date: 2024-11-04. Results received: No. Last updated: 2026-02-18.
Decision dates by country: DE: 2024-11-08, ES: 2024-11-04

Condition(s): Non-Small Cell Lung Cancer
Product: LY2875358, ERLOTINIB

Primary endpoint: The primary endpoint of the study is progression-free survival (PFS). PFS is defined as the time from the date of study randomization to the date of first observation of objective radiographic progression or death from any cause as defined by RECIST 1.1 (Eisenhauer et al. 2009). If a patient is event-free at analysis, the patient will be censored at the last progression-free tumor assessment.

Source: https://euclinicaltrials.eu/ctis-public/view/2024-514268-18-00